EU clinical trial 2026-525214-62-00: Neoadjuvant Immunotherapy and Organ-sparing Treatment in Patients with Stage I-III dMMR Colon Cancer: A National, Multicentre, Personalised, Phase II Study (RESET C2)
Sponsor: Region Sjaelland (Hospital/Clinic/Other health care facility). Phase: Therapeutic exploratory (Phase II). Countries: Denmark (authorised, recruitment pending).
Therapeutic area(s): Diseases [C] - Neoplasms [C04]; Diseases [C] - Digestive System Diseases [C06]
Gender: Female, Male. Age: 18-64 years, 65+ years. Enrolment: 152.
Status: Authorised, recruitment pending. Decision date: 2026-05-07. Results received: No. Last updated: 2026-05-07.

Condition(s): Localised dMMR Colon Cancer
Product: KEYTRUDA 25 mg/mL concentrate for solution for infusion.

Primary endpoint: Compete Clinical response: Local response on endoscopy, no metastatic disease on CT imaging at reassessment
Endpoint(s): Overall Survival: Death from any cause from inclusion to 36 months after, Disease Free Survival: Death from any cause or disease recurrence from inclusion to 36 months after, Response Rates in Surgical Patients: Rates of complete pathological response (Mandard Tumour Grade Regression 1) and major pathologic response (Mandard Tumour Grade Regression 1 and 2), Adverse Events to Pembrolizumab: As defined by the NCI Common Terminology Criteria for Adverse Events, from pembrolizumab administration to 12 months post, Adverse events related to surgery: Surgical Complications as defined by the Clavien-Dindo classification system from the day of surgery to 90 days postoperatively, Adverse events related to endoscopy: As defined by the ASGE Lexicon, from the day of endoscopy to 7 days after, Healthcare Utilisation: As defined as planned or unplanned use of hospital admissions from inclusion to 90 days post definitive treatment, Healthcare Utilisation: As defined as planned or unplanned use of intensive care admissions from inclusion to 90 days post definitive treatment, Healthcare Utilisation: As defined as planned or unplanned use of outpatient encounters from inclusion to 90 days post definitive treatment, Quality of Life: As defined as a change in the EORTC QLQ-C30 between patients in watchful waiting, patients who undergo surgery after neoadjuvant treatment and patients in the surgical comparator group before, during and 3, 6, 12, 24 and 60 months post treatment, Quality of Life: As defined as a change in the EORTC QLQ-CR29 between patients in watchful waiting, patients who undergo surgery after neoadjuvant treatment and patients in the surgical comparator group before, during and 3, 6, 12, 24 and 60 months post treatment, Quality of Life: As defined as a change in the Colon Cancer Dysfunction Score between patients in watchful waiting, patients who undergo surgery after neoadjuvant treatment and patients in the surgical comparator group before, during and 3, 6, 12, 24 and 60 months post treatment, Quality of Life: As defined as a change in the EQ-5D-5L between patients in watchful waiting, patients who undergo surgery after neoadjuvant treatment and patients in the surgical comparator group before, during and 3, 6, 12, 24 and 60 months post treatment, Quality of Life: As defined as a change in the FACIT-Fatigue between patients in watchful waiting, patients who undergo surgery after neoadjuvant treatment and patients in the surgical comparator group before, during and 3, 6, 12, 24 and 60 months post treatment, Quality of Life: As defined as a change in the Fear of Cancer Recurrence Short Form between patients in watchful waiting, patients who undergo surgery after neoadjuvant treatment and patients in the surgical comparator group before, during and 3, 6, 12, 24 and 60 months post treatment, Quality of Life: As defined as a change in the Quality of Recovery 15 questionnaire measured at post operative day 0, 2 and 14 compared between the patients who undergo surgery after neoadjuvant treatment against patients in the comparator group, Efficacy of prehabilitation: As measured as changes in the 6 minute walk test in patients who undergo supervised training as part of their prehabilitation at enrolment, after each cycle of immunotherapy and 3 months after definitive treatment, Efficacy of prehabilitation: As measured as changes in the Sit to Stand Test in patients who undergo supervised training as part of their prehabilitation at enrolment, after each cycle of immunotherapy and 3 months after definitive treatment, Efficacy of prehabilitation: As measured as changes in the hand grip strength test in patients who undergo supervised training as part of their prehabilitation at enrolment, after each cycle of immunotherapy and 3 months after definitive treatment, Efficacy of prehabilitation: As measured as changes in the BORG Scale in patients who undergo supervised training as part of their prehabilitation at enrolment, after each cycle of immunotherapy and 3 months after definitive treatment, Efficacy of prehabilitation: As measured as changes in the G8 frailty score in patients who undergo supervised training as part of their prehabilitation at enrolment, after each cycle of immunotherapy and 3 months after definitive treatment, Efficacy of Prehabilitation: As defined as a change in the NPAQ-Short at at inclusion, during treatment and 3, 6, 12, 24 and 60 months post treatment

Source: https://euclinicaltrials.eu/ctis-public/view/2026-525214-62-00